EU clinical trial 2022-501557-36-00: OBI-WAN : Obinutuzumab for remission induction in patients with relapsing PR3-ANCA granulomatosis with polyangiitis (Wegener’s). Phase 2 prospective, open-label study
Protocol code: APHP211000
Sponsor: Assistance Publique Hopitaux De Paris (Hospital/Clinic/Other health care facility). Phase: Therapeutic exploratory (Phase II). Countries: France (ongoing, recruiting).
Therapeutic area(s): Diseases [C] - Immune System Diseases [C20]
Gender: Female, Male. Age: 18-64 years, 65+ years. Enrolment: 36.
Status: Ongoing, recruiting. Start date (EU): 2025-12-19. Decision date: 2025-03-27. Results received: No. Last updated: 2025-12-15.

Condition(s): PR3-ANCA granulomatosis with polyangiitis (Wegener’s)
Product: Gazyvaro 1,000 mg concentrate for solution for infusion.

Primary endpoint: The percentage of patients who achieved clinical and serological remission at week 24 (month 6), defined by: 1) a BVAS of 0; 2) a negativation of PR3-ANCA; 3) a successful completion of the prednisone taper
Endpoint(s): The number of adverse events, expressed as adverse events according to the CTCAE toxicity grading system per patient-year at week 24 and 52 for the following adverse events combined: death (all causes), grade 2 or higher leukopenia or thrombocytopenia, grade 3 or higher infections, hemorrhagic cystitis, malignancies, venous thromboembolic events, hospitalization resulting either from the disease or from a complication due to the study treatment, infusion reactions (within 24 hours of infusion, Number and causes of deaths over the 12 months study period, Proportion of participants who had vasculitis relapses (BVAS > 0), including minor and major relapses over the 12 months study period, Proportion of participants who remain with a BVAS of 0 during the treatment period with prednisone at a dose of less than 10 mg per day, The time to B-cell repopulation defined by detectable CD19+ B cells in peripheral blood over the 12 months study period, The patient-reported outcomes (PRO) including HAQ and SF-36, patient-reported disease activity, anxiety and depression, burden of the disease and treatment and adherence to treatment, at week 24 and 52, The Vasculitis Damage Index at week 24 and 52

Source: https://euclinicaltrials.eu/ctis-public/view/2022-501557-36-00